EU clinical trial 2024-512643-23-00: A phase I/IIa clinical trial to assess feasibility, safety and antitumor activity of autologous SLAMF7 CAR-T cells in multiple myeloma
Protocol code: CARAMBA-1
Sponsor: Universitaetsklinikum Wuerzburg AöR (Hospital/Clinic/Other health care facility). Phase: Phase I and Phase II (Integrated)- First administration to humans. Countries: Germany (ongoing, recruitment ended).
Therapeutic area(s): Diseases [C] - Neoplasms [C04]; Diseases [C] - Hemic and Lymphatic Diseases [C15]
Gender: Female, Male. Age: 18-64 years, 65+ years. Enrolment: 33.
Status: Ongoing, recruitment ended. Start date (EU): 2020-06-22. Decision date: 2025-01-30. Results received: No. Last updated: 2026-07-16.

Condition(s): Multiple myeloma
Product: SLAMF7 C2, SLAMF7 C5, SLAMF7 C4, SLAMF7 C3, SLAMF7 C1

Primary endpoint: 1.) Phase I: Type, frequency, and severity of adverse events (AEs), including serious adverse events (SAEs), cytokine release syndrome (CRS), and neurotoxicity (i.e. immune effector cell-associated neurotoxicity syndrome [ICANS]), 2.) Phase I: MTD of SLAMF7 CAR-T that can be administered in phase IIa will be assessed at the end of phase I, 3.) Phase IIa: Type, frequency, and severity AEs, including SAEs, CRS, and neurotoxicity (i.e. ICANS), 4.) Phase IIa: Percentage of patients who achieved partial response (PR) or better using the IMWG Uniform Response Criteria for Multiple Myeloma at Months 1, 2, 3, 4, 5, 6, 9, 12, 15, 18, 21 and 24 after SLAMF7 CAR-T infusion
Endpoint(s): 1.) Phase IIa: Percentage of patients who achieved CR or better using the IMWG Uniform Response Criteria for Multiple Myeloma at Months 1, 2, 3, 4, 5, 6, 9, 12, 15, 18, 21 and 24 after SLAMF7 CAR-T infusion, 2.) Phase I and IIa: Percentage of myeloma patients enrolled into the trial who receive ex vivo expanded autologous SLAMF7 CAR-T within the 48h shelf-life of the product, 3.) Phase I and IIa: Maximum peak in SLAMF7 CAR-T (Cmax), time to peak of SLAMF7 CAR-T (Tmax), area under the curve of CAR-T CD4+ and CD8+ cells (AUC), including maximum expansion and duration of persistence of SLAMF7 CAR-T cells at Baseline, Days 1, 3, 7, 10, 14, 21, 28, Week 6, 8, 12, Months 4, 5, 6, 7, 8, 9, 10, 11, 12, 15, 18, 21, 24, 4.) Phase I and IIa: a) Time between first SLAMF7 CAR-T infusion and first documentation of response at Months 1, 2, 3, 4, 5, 6, 9, 12, 15, 18, 21, 24; b) Time between first response and disease progression PD or death at Months 1, 2, 3, 4, 5, 6, 9, 12, 15, 18, 21, 24 c) Time between SLAMF7 CAR-T infusion and first documentation of PD or death at Months 1, 2, 3, 4, 5, 6, 9, 12, 15, 18, 21, 24 d) Phase I and IIa: Proportion of minimal residual disease (MRD) evaluable patients that are MRD negativ, 5.) Phase I and IIa: Time between SLAMF7 CAR-T infusion and time of death at Months 1, 2, 3, 4, 5, 6, 9, 12, 15, 18, 21, 24, 6.) Patient-reported outcomes as measured by EORTC-QLQ-C30/-MY20 at Screening, Baseline, Months 6, 12, 24

Source: https://euclinicaltrials.eu/ctis-public/view/2024-512643-23-00